EU clinical trial 2024-514496-18-01: An open-label, prospective, randomised, cross-over trial to assess the pharmacokinetics of an amorphous formulation of sorafenib in mesoporous magnesium carbonate (DPH001) compared to Nexavar® (sorafenib) in healthy volunteers
Protocol code: DPH001-01
Sponsor: Disruptive Pharma AB (Pharmaceutical company). Phase: Human Pharmacology (Phase I)- Other. Countries: Sweden (ended).
Therapeutic area(s): Not possible to specify
Gender: Female, Male. Age: 18-64 years, 65+ years. Enrolment: 12.
Status: Ended. Start date (EU): 2025-01-30. End date (EU): 2025-03-10. Decision date: 2025-01-15. Results received: No. Last updated: 2025-01-15.

Condition(s): Hepatocellular carcinoma, renal cell carcinoma and differentiated thyroid carcinoma.

Source: https://euclinicaltrials.eu/ctis-public/view/2024-514496-18-01